EU clinical trial 2024-514882-20-00: Riluzole for the treatment of spasticity in the traumatic chronic spinal cord injury condition: Adaptive, Multicenter, placebo-controlled, randomised, double blind trial in a Rare Disorder
Sponsor: Centre Hospitalier Regional De Marseille (Hospital/Clinic/Other health care facility). Phase: Phase I and Phase II (Integrated)- Bioequivalence Study. Countries: France (ongoing, recruiting).
Therapeutic area(s): Diseases [C] - Musculoskeletal Diseases [C05]
Gender: Female, Male. Age: 18-64 years, 65+ years. Enrolment: 90.
Status: Ongoing, recruiting. Start date (EU): 2024-07-31. Decision date: 2024-07-31. Results received: No. Last updated: 2024-07-31.

Condition(s): spasticity
Product: Placebo Riluzole caps prep, Riluzole 25 caps prep, Riluzole 50 caps prep

Primary endpoint: the improvement of Modified Ashworth Score better than 1 point, or 11 points Numerical Rating Scale (0-10 NRS) spasticity score better than 20% between Week 0 and Week 2.
Endpoint(s): Safety : side effects, Pharmacokinetics (PK): Blood sampling time points will be estimated using Limited Sampling Strategy (according to the selected galenic form and sex). Individual PK parameters will be calculated using standard compartimental approaches. In particular, exposure parameters (i.e., Cmax, Ctrough, AUC) will be evaluated., Electrophysiology: H reflex, mean F wave amplitude, surface EMG at T0 (before drug intake) at T2h (2h after drug intake) (only in Step 2), Efficacy : 0-10 NRS score, Modified Ashworth score (MAS) on at least adductor muscles and/or triceps surae, Patient Global Impression of Change, Penn Spasm frequency scale, Pain : Visual Analog Scales, Neuropathic Pain Symptom Inventory, International Spinal Cord Injury Basic Data Set (ISCIPDS), Activities and Participation: Spinal Cord Injury Independence Measure (SCIM scale) (only in Step 2); Personal therapeutic objectives determined at baseline, Goal Attainment Scale (GAS) (Adductor muscle spasticity...), Bladder dysfunction: Bladder diary (items on urinary frequency, daytime incontinence...) (Only in Step 2)

Source: https://euclinicaltrials.eu/ctis-public/view/2024-514882-20-00